EU clinical trial 2025-521923-58-00: Role of Neuroinflammation and Blood-Brain Barrier Breakdown in Intracerebral Hemorrhage. The INFINITE Study
Sponsor: Centre Hospitalier Universitaire De Toulouse (Hospital/Clinic/Other health care facility). Phase: Therapeutic exploratory (Phase II). Countries: France (authorised, recruitment pending).
Therapeutic area(s): Diseases [C] - Nervous System Diseases [C10]
Gender: Female, Male. Age: 18-64 years, 65+ years. Enrolment: 117.
Status: Authorised, recruitment pending. Decision date: 2025-10-10. Results received: No. Last updated: 2026-06-01.

Condition(s): Intracerebral hemorrhage.
Product: 18F-DPA-714

Primary endpoint: o 18F-DPA-714 binding is measured by the mean standard uptake value ratio (SUVR) within the perihematomal edema (PHE) using the mirror region of interest (ROI) in the contralateral hemisphere as reference, o The functional outcome at 6 months after ICH is quantified by the modified Rankin scale (which ranges from 0 [no symptoms] to 6 [death]). Poor functional outcome is defined as a modified Rankin scale score (mRs) ≥3
Endpoint(s): o Volume of brain tissue within the perihematomal area with increased 18F-DPA-714 binding, o voxel-wise 18F-DPA-714 levels based on SuperVised Cluster Analysis (SVCA)., The associations of PET-derived quantitative measures of 18F-DPA-714 radiotracer uptake with: o Neurological deterioration within 14 days after ICH onset, defined as a ≥4‐point increase on the National Institutes of Health Stroke Scale (NIHSS) or ≥2‐point decrease on the Glasgow Coma Scale compared to baseline scores at the pre-inclusion visit;, o Early death defined as death at day 30, o Clinical outcome at 6 months assessed by the distribution of modified Rankin scale scores, o Mortality at 6 months, o MRI-derived quantitative measures of BBB breakdown (based on maps of the contrast agent transfer coefficient, Ktrans) in the perihematomal area at day 10 ±2 after ICH, o Plasma levels of inflammatory biomarkers (including MMP9, TNF alpha, IL-6 and -10, soluble TLR 2/4, Neutrophil Extracellular Traps –(NETs)) at day 10 ±2 after ICH onset, • The comparison of MRI-derived quantitative measures of BBB breakdown and plasma levels of inflammatory biomarkers between patients with poor vs favorable functional outcome at 6 months, • Performance of PET-derived quantitative measures of 18F-DPA-714 radiotracer uptake, MRI-derived quantitative measures of BBB breakdown, and plasma levels of inflammatory biomarkers to predict the functional outcome at 6 months, assessed by receiver operating characteristic (ROC) curve analyses and area under curve (AUC) values, • The associations of baseline clinical and imaging variables with: o PET-derived quantitative measure of 18F-DPA-714 PET radiotracer uptake o MRI-derived quantitative measures of BBB breakdown

Source: https://euclinicaltrials.eu/ctis-public/view/2025-521923-58-00